EU clinical trial 2024-514376-40-00: An Open-label Randomized Phase 2 Study to Evaluate Safety and Efficacy of Patritumab Deruxtecan Plus Pembrolizumab Administered Either Before or After Carboplatin/Paclitaxel Plus Pembrolizumab Compared With Pembrolizumab in Combination With Chemotherapy Followed by Surgery and Adjuvant Pembrolizumab for High-Risk Early-Stage Triple-Negative or Hormone Receptor-Low Positive/Human Epidermal Growth Factor Receptor-2 Negative Breast Cancer (HERTHENA-Breast03)
Protocol code: MK-1022-010
Sponsor: Merck Sharp & Dohme LLC (Pharmaceutical company). Phase: Therapeutic exploratory (Phase II). Countries: Spain (ongoing, recruiting).
Therapeutic area(s): Diseases [C] - Neoplasms [C04]
Gender: Female, Male. Age: 18-64 years, 65+ years. Enrolment: 10.
Status: Ongoing, recruiting. Start date (EU): 2025-10-15. Decision date: 2025-04-21. Results received: No. Last updated: 2026-08-04.

Condition(s): High Risk Early-Stage Triple Negative Breast Cancer (TNBC) or Hormone Receptor Low Positive/Human Epidermal Growth Factor Receptor 2 Negative (HR-low+/HER2-) Breast Cancer
Product: PACLITAXEL, KEYTRUDA 25 mg/mL concentrate for solution for infusion, DOXORUBICIN, OLAPARIB, CARBOPLATIN, CAPECITABINE, MK-1022, EPIRUBICIN, CYCLOPHOSPHAMIDE

Primary endpoint: Part 1: Number of Participants Experiencing an Adverse Event (AE), Part 1: Number of Participants Who Experience One or More Dose-Limiting Toxicities (DLTs), Part 1: Number of Participants who Discontinued Study Treatment Due to an AE, Part 2: Pathological Complete Response (pCR) Rate Using the Definition of ypT0/Tis ypN0, Part 2: Number of Participants Experiencing an Adverse Event (AE), Part 2: Number of Participants who Discontinued Study Treatment Due to an AE
Endpoint(s): Part 2: Pathological Complete Response (pCR) Rate Using the Definition of ypT0 ypN0, Part 2: Event-Free Survival (EFS), Part 2: Overall Survival (OS), Part 2: Distant Progression or Distant Recurrence-Free Survival (DPDRFS), Part 2: Residual Cancer Burden (RCB)

Source: https://euclinicaltrials.eu/ctis-public/view/2024-514376-40-00